EU clinical trial 2024-515939-30-01: Clinical trial on the virucidal activity of different oral antiseptics against respiratory viruses.
Protocol code: OralAntiseptic_Virus
Sponsor: Fundacion Instituto De Investigacion Sanitaria De Santiago De Compostela (Patient organisation/association). Phase: Therapeutic use (Phase IV). Countries: Spain (authorised, recruitment pending).
Therapeutic area(s): Diseases [C] - Virus Diseases [C02]
Gender: Female, Male. Age: 0-17 years, 18-64 years, 65+ years. Enrolment: 810.
Status: Authorised, recruitment pending. Decision date: 2025-04-14. Results received: No. Last updated: 2025-04-14.

Condition(s): Respiratory diseases
Product: Betadine bucal 100 mg/ml solución bucal, Agua oxigenada Foret 3 % solución cutánea y concentrado para solución bucal, Agua para preparaciones inyectables Meinsol, disolvente para uso parenteral

Primary endpoint: Viral load in the salivary samples collected from each of the patients at the different times of application of the mouthwashes., D/T ratio (where D is the amount of nucleoprotein with the PBS solution and T is the amount of nucleoprotein with the lytic solution), which represents the reciprocal relationship between the enveloped nucleoprotein and the total nucleoprotein (I/T) and corresponds to I/T = 1 -D/T. In this case, the I/T ratio serves to quantify the proportion of intact viral particles.

Source: https://euclinicaltrials.eu/ctis-public/view/2024-515939-30-01